EU clinical trial 2024-512259-19-00: A Phase 2 Open-Label Study to Evaluate the Safety and Efficacy of DCR-PHXC in Patients With Primary Hyperoxaluria Type 1 and Severe Renal Impairment, With or Without Dialysis
Protocol code: DCR-PHXC-204
Sponsor: Dicerna Pharmaceuticals Inc. (Pharmaceutical company). Phase: Therapeutic exploratory (Phase II). Countries: Germany (ongoing, recruitment ended), Spain (ongoing, recruitment ended), Italy (ended).
Therapeutic area(s): Diseases [C] - Nutritional and Metabolic Diseases [C18]
Gender: Female, Male. Age: 0-17 years, 18-64 years. Enrolment: 6.
Start date (EU): 2021-04-08. Decision date: 2024-09-16. Results received: No. Last updated: 2026-04-30.
Decision dates by country: IT: 2024-11-04, DE: 2024-09-17, ES: 2024-09-16

Condition(s): Primary Hyperoxaluria

Primary endpoint: The absolute and percent change in Pox from Baseline to Day 180.
Endpoint(s): Absolute and percent change in Pox from Baseline to maximum reduction through Day 180., Change in the hemodialysis or peritoneal dialysis regimen., Change in stone burden identified via ultrasound from Baseline to Day 180., Change in nephrocalcinosis score., Change in cardiac oxalosis.

Source: https://euclinicaltrials.eu/ctis-public/view/2024-512259-19-00